EU clinical trial 2025-525150-19-01: A multicenter, randomized, controlled, open-label, parallel-group clinical trial in men who have sex with men (MSM) and transgender women with risk sexual behaviors for sexually transmitted infections.
Protocol code: MiDoxyR-PEP
Sponsor: Instituto De Investigacion Marques De Valdecilla (Laboratory/Research/Testing facility). Phase: Therapeutic use (Phase IV). Countries: Spain (authorised, recruitment pending).
Therapeutic area(s): Diseases [C] - Bacterial Infections and Mycoses [C01]; Diseases [C] - Virus Diseases [C02]
Gender: Male. Age: 18-64 years, 65+ years. Enrolment: 392.
Status: Authorised, recruitment pending. Decision date: 2026-08-06. Results received: No. Last updated: 2026-08-06.

Condition(s): Colonization by methicillin-resistant S. aureus and gut microbiota in users of pre-exposure prophylaxis (PrEP) and people living with HIV (PLHIV) with STIs.
Product: Juluca 50 mg/25 mg film-coated tablets, Triumeq 50 mg/600 mg/300 mg film-coated tablets, Dovato 50 mg/300 mg film-coated tablets, DOXYCYCLINE, Odefsey 200 mg/25 mg/25 mg film-coated tablets, Biktarvy 30 mg/120 mg/15 mg film-coated tablets, TENOFOVIR DISOPROXIL AND EMTRICITABINE

Primary endpoint: to assess the prevalence of nasal colonization by doxycycline-resistant S. aureus strains
Endpoint(s): To assess differences in the composition of the baseline gut microbiota and at month 12, To assess the development of resistance in the gut microbiota, To assess the prevalence of infections caused by T. pallidum, C. trachomatis, and N. gonorrhoeae, and doxycycline-resistant C. trachomatis.

Source: https://euclinicaltrials.eu/ctis-public/view/2025-525150-19-01